EU clinical trial 2025-522514-23-00: J2A-MC-GZPS: A Master Protocol to Investigate the Efficacy and Safety of Orforglipron Tablet Once Daily Compared with Placebo in Female Participants with Stress Urinary Incontinence Who Have Obesity or Overweight (RESTRAIN-SUI) ; J2A-MC-GZS1: A Study to Investigate Efficacy and Safety of Orforglipron Once Daily in Participants with Stress Urinary Incontinence Who Have Obesity or Overweight ; J2A-MC-GZS2: A Study to Investigate Efficacy and Safety of Orforglipron Once Daily in Participants with Stress Urinary Incontinence Who Have Obesity or Overweight
Protocol code: J2A-MC-GZPS
Sponsor: Eli Lilly & Co. (Pharmaceutical company). Phase: Therapeutic confirmatory (Phase III). Countries: Romania (ongoing, recruiting), Czechia (ongoing, recruiting), Poland (ongoing, recruiting).
Therapeutic area(s): Diseases [C] - Female Urogenital Diseases and Pregnancy Complications [C13]
Gender: Female. Age: 18-64 years. Enrolment: 295.
Status: Ongoing, recruiting. Start date (EU): 2026-02-12. Decision date: 2026-01-26. Results received: No. Last updated: 2026-04-23.
Decision dates by country: CZ: 2026-01-26, RO: 2026-01-28, PL: 2026-02-09

Condition(s): Urinary Incontinence, Stress
Product: Placebo to match ly, Orforglipron, Orforglipron, Orforglipron, Orforglipron, Orforglipron, Orforglipron

Primary endpoint: Change from Baseline in Incontinence Episode Frequency (IEF)

Source: https://euclinicaltrials.eu/ctis-public/view/2025-522514-23-00